EU clinical trial 2025-521117-88-00: A Double-blind, Randomized, Placebo-controlled, Multi-center Study Evaluating the Safety, Tolerability, and Effect of Olpasiran on Coronary Artery Plaque Burden Assessed by Coronary Computed Tomography Angiography in Participants With Stable Atherosclerotic Cardiovascular Disease and Elevated Lipoprotein(a)
Protocol code: 20230191
Sponsor: Amgen Inc. (Pharmaceutical company). Phase: Therapeutic confirmatory (Phase III). Countries: France (ongoing, recruiting), Denmark (ongoing, recruiting), Germany (ongoing, recruiting), Spain (authorised, recruiting), Italy (ongoing, recruiting), Netherlands (authorised, recruiting).
Therapeutic area(s): Diseases [C] - Cardiovascular Diseases [C14]
Gender: Female, Male. Age: 18-64 years, 65+ years. Enrolment: 178.
Start date (EU): 2026-03-11. Decision date: 2025-12-22. Results received: No. Last updated: 2026-06-19.
Decision dates by country: DK: 2025-12-22, FR: 2025-12-22, IT: 2025-12-23, NL: 2026-01-05, ES: 2026-02-02, DE: 2026-01-08

Condition(s): Cardiovascular Disease
Product: Olpasiran, Placebo for AMG 890

Primary endpoint: change in non-calcified plaque volume from baseline to week 72
Endpoint(s): change in the following volume types from baseline to week 72: -low attenuation plaque volume -total plaque volume -calcified plaque volume

Source: https://euclinicaltrials.eu/ctis-public/view/2025-521117-88-00